EU clinical trial 2024-519516-14-01: The effect of androgen deprivation therapy on the expression of prostate specific membrane antigen (PSMA) in treatment naive metastatic prostate cancer
Sponsor: Turku University Hospital (Hospital/Clinic/Other health care facility). Phase: Therapeutic exploratory (Phase II). Countries: Finland (ongoing, recruiting).
Therapeutic area(s): Diseases [C] - Male Urogenital Diseases [C12]; Diseases [C] - Neoplasms [C04]; Diseases [C] - Hormonal diseases [C19]
Gender: Male. Age: 18-64 years, 65+ years. Enrolment: 35.
Status: Ongoing, recruiting. Start date (EU): 2019-04-15. Decision date: 2025-01-28. Results received: No. Last updated: 2025-01-28.

Condition(s): Metastatic prostate cancer, Prostate cancer
Product: DEGARELIX

Primary endpoint: To demonstrate that PSMA-flare seen 2-3weeks after initiation of ADT at baseline is more common in bony lesions than in prostatic lesions
Endpoint(s): To study if metastatic lesions with and without PSMA-flare seen in baseline behave differently in repeated 18F-PSMA-PET CT at the time of CRPC, To compare the metastatic load seen in 18F-PSMA-PET CT and FDGPET- CT at baseline (Sub-study 1), To determine the total androgen profile during the evolution of metastatic Pca by repeated total androgen measurements in every six months from diagnosis to the development of CRPC (Sub-study 2), To biopsy prostate lesions seen on 18F-PSMA PET and determine if the changes of PSMA uptake after ADT might have a histopathological correlation (Substudy 3), To investigate gut microbiome and its changes during ADT (Substudy 4)

Source: https://euclinicaltrials.eu/ctis-public/view/2024-519516-14-01